EU clinical trial 2023-504957-11-00: MK-5684-004: A Phase 3, Randomized, Open-label Study of Opevesostat Versus Alternative Abiraterone Acetate or Enzalutamide in Participants with Metastatic Castration-resistant Prostate Cancer (mCRPC) That Progressed On or After Prior Treatment With One Next-generation Hormonal Agent (NHA) (OMAHA-004)
Protocol code: MK-5684-004
Sponsor: Merck Sharp & Dohme LLC (Pharmaceutical company). Phase: Therapeutic confirmatory (Phase III). Countries: Lithuania (ongoing, recruiting), Romania (ongoing, recruiting), Sweden (ongoing, recruiting), Italy (ongoing, recruiting), Estonia (ongoing, recruiting), Germany (ongoing, recruiting), Portugal (ongoing, recruiting), Greece (ongoing, recruiting), Slovakia (ongoing, recruiting), Spain (ongoing, recruiting), France (ongoing, recruiting), Hungary (ongoing, recruiting), Latvia (ongoing, recruiting), Ireland (ongoing, recruiting), Czechia (ongoing, recruiting).
Therapeutic area(s): Diseases [C] - Neoplasms [C04]
Gender: Male. Age: 18-64 years, 65+ years. Enrolment: 401.
Status: Ongoing, recruiting. Start date (EU): 2026-03-24. Decision date: 2024-03-19. Results received: No. Last updated: 2026-07-02.
Decision dates by country: LV: 2024-03-21, IE: 2024-03-22, HU: 2024-04-04, SK: 2024-03-19, SE: 2024-03-21, RO: 2024-03-25, FR: 2024-03-19, ES: 2024-03-22, LT: 2024-03-25, EE: 2024-03-22, CZ: 2024-03-19, DE: 2024-03-20, IT: 2024-03-20, PT: 2024-03-20, GR: 2024-03-26

Condition(s): Metastatic castration resistant prostate cancer
Product: PREDNISONE, DEXAMETHASONE ACETATE, Opevesostat, ENZALUTAMIDE, FLUDROCORTISONE ACETATE, HYDROCORTISONE, PREDNISONE ACETATE, HYDROCORTISONE, PREDNISOLONE, FLUDROCORTISONE, HYDROCORTISONE, HYDROCORTISONE, DEXAMETHASONE, ABIRATERONE ACETATE, HYDROCORTISONE, ABIRATERONE ACETATE

Primary endpoint: Radiographic Progression-free Survival (rPFS)
Endpoint(s): Overall Survival (OS), Time to Initiation of the First Subsequent Anticancer Therapy (TFST), Objective Response Rate (ORR), Duration of Response (DOR), Time to Pain Progression (TTPP), Change From Baseline in Functional Assessment of Cancer Therapy-General (FACT-G) Total Score, Time to Deterioration (TTD) in FACT-G Total Score, Overall Improvement in FACT-G Total Score, Time to Prostate-specific Antigen (PSA) progression, PSA Response Rate, Time to first symptomatic skeletal-related event (TSSRE), Number of Participants Who Experience an Adverse Event (AE), Number of Participants Who Discontinue Study Treatment Due to an AE

Source: https://euclinicaltrials.eu/ctis-public/view/2023-504957-11-00